EU clinical trial 2023-506393-12-00: A phase 1 study of JNJ-86974680, an A2a receptor antagonist, administered as monotherapy and in combination with cetrelimab and radiotherapy for advanced non-small cell lung cancer
Sponsor: Johnson And Johnson Enterprise Innovation Inc. (Pharmaceutical company). Phase: Human Pharmacology (Phase I)- First administration to humans. Countries: Germany (ongoing, recruitment ended), Spain (ongoing, recruitment ended).
Therapeutic area(s): Diseases [C] - Neoplasms [C04]
Gender: Female, Male. Age: 18-64 years, 65+ years. Enrolment: 50.
Status: Ongoing, recruitment ended. Start date (EU): 2024-02-13. Decision date: 2024-01-15. Results received: No. Last updated: 2026-03-02.
Decision dates by country: DE: 2024-01-15, ES: 2024-01-18

Condition(s): Advanced non-small cell lung cancer

Source: https://euclinicaltrials.eu/ctis-public/view/2023-506393-12-00